EU clinical trial 2024-514074-40-00: DEROTOX : DEgenerative ROtator cuff disease and botulinum TOXin
Protocol code: APHP210416
Sponsor: Assistance Publique Hopitaux De Paris (Hospital/Clinic/Other health care facility). Phase: Therapeutic exploratory (Phase II). Countries: France (ongoing, recruiting).
Therapeutic area(s): Diseases [C] - Musculoskeletal Diseases [C05]
Gender: Female, Male. Age: 18-64 years, 65+ years. Enrolment: 60.
Status: Ongoing, recruiting. Start date (EU): 2023-01-20. Decision date: 2024-07-22. Results received: No. Last updated: 2025-03-03.

Condition(s): Degenerative shoulder rotator cuff tendinopathy
Product: XEOMIN 100 unités, poudre pour solution injectable, Placebo of Xeomin 100 UI, powder for injection

Primary endpoint: Total SPADI score at 1 month.
Endpoint(s): Total SPADI score at 3 months, SPADI sub-scores at 3 months, Perceived overall improvement, by VAS at 1 and 3 months, Painkiller medication consumption over the 3 months of follow-up, Acceptability of treatment by VAS from 0 to 100 at 1 month and 3 months

Source: https://euclinicaltrials.eu/ctis-public/view/2024-514074-40-00